EU clinical trial 2022-501057-36-00: A multicenter randomized trial to evaluate the efficacy of pioglitazone to promote renal tolerance in ANCA-associated vasculitis - RENATO
Protocol code: APHP211045
Sponsor: Assistance Publique Hopitaux De Paris (Hospital/Clinic/Other health care facility). Phase: Therapeutic confirmatory (Phase III). Countries: France (ongoing, recruiting).
Therapeutic area(s): Diseases [C] - Immune System Diseases [C20]
Gender: Female, Male. Age: 18-64 years, 65+ years. Enrolment: 126.
Status: Ongoing, recruiting. Start date (EU): 2023-10-24. Decision date: 2023-04-17. Results received: No. Last updated: 2026-01-26.

Condition(s): ANCA-associated vasculitis
Product: PREDNISONE, DEXCHLORPHENIRAMINE, PARACETAMOL, Actos 30 mg tablets, METHYLPREDNISOLONE HEMISUCCINATE, Placebo of ACTOS 30 mg tablets (Pioglitazone), METHYLPREDNISOLONE, RITUXIMAB, RITUXIMAB

Primary endpoint: Improvement of serum creatinine (Delta sCreat) >30% of inclusion value (if initial sCreat is >135 µmol/L) AND urine proteine-to-creatinine (uPCR) <1g/g, at week 26. A pre-specified subgroup analysis will be performed in patients according to age, renal pathology, initial renal function, de novo vs relapsing vasculitis and ANCA specificity.
Endpoint(s): Improvement of renal function (Delta sCreat, eGFR), renal survival and proteinuria at weeks 4, 12, 26, 52: -Renal function evaluated by Delta sCreat (sCreat at inclusion-sCreat follow-up), sCreat slopes, eGFR modifications (CKD-Epi formula); -Renal survival evaluated as the % of patients still alive and not requiring chronic dialysis therapy; -Proteinuria measured by spot uPCR; -Reduction of systemic chronic damage due to vasculitis; -Vasculitis-associated damage assessed by VDI at weeks 26 & 52, Reduction of vasculitis activity at weeks 4, 12, 26, 52: -Residual activity of renal vasculitis evaluated by urine biomarkersme asurement: microhematuria, levels of urinary MCP-1, KIM-1, Calprotectin, CD163; -Systemic vasculitis activity assessed by the BVAS and by ANCA positivity; Percentage of patients with refractory vasculitis resistance and early vasculitis relapse at weeks 12, 26 & 52, Improvement of Quality of Life during follow-up, measured by Short Form-36 component and domain scores and the EQ-5D-5L visual analogue scale and index at week 4, 12, 26, 52, Safety of pioglitazone by evaluation of numbers of adverse events, number of patients with adverse events, numbers of serious adverse events, patient survival, at weeks 26 & 52. In addition, cardiac and liver toxicity of pioglitazone will be evaluated by assessment of plasma BNP and liver enzymes, Reduction of glucocorticoid-induced toxicity during follow-up: -Glucocorticoid-induced toxicity measured by GTI at weeks 12, 26 & 52 -Metabolic effects of glucocorticoids will be evaluated by HbA1c levels & evaluation of lipid profile (Total, HDL and LDL cholesterol, triglycerides) at weeks 12, 26 & 52; Reduction of nephropathy-induced hypertension and numbers of antihypertensive drugs given during follow-up; -Hypertension evaluated by office measurement at each study visit & AMBP at weeks 12&26

Source: https://euclinicaltrials.eu/ctis-public/view/2022-501057-36-00